EU clinical trial 2023-509782-20-00: A Randomized, Double-blind, Placebo-controlled, Repeat-dose, Multicenter Trial to Evaluate the Efficacy, Safety, Tolerability and Pharmacokinetics of HZN-825 in Patients with Diffuse Cutaneous Systemic Sclerosis [HZNP-HZN-825-301]
Protocol code: HZNP-HZN-825-301
Sponsor: Horizon Therapeutics Ireland Designated Activity Company (Pharmaceutical company). Phase: Therapeutic exploratory (Phase II). Countries: Romania (ended), Austria (ended), Germany (ended), Greece (ended), Spain (ended), Poland (ended), France (ended), Portugal (ended), Italy (ended).
Therapeutic area(s): Diseases [C] - Immune System Diseases [C20]
Gender: Female, Male. Age: 18-64 years, 65+ years. Enrolment: 84.
Status: Ended. Start date (EU): 2021-11-11. End date (EU): 2024-12-19. End date: 2025-02-24. Decision date: 2024-06-24. Results received: Yes. Last updated: 2025-02-25.
Decision dates by country: RO: 2024-07-01, IT: 2024-07-01, ES: 2024-06-24, PL: 2024-07-17, FR: 2024-07-29, DE: 2024-06-26, GR: 2024-09-09, AT: 2024-08-05, PT: 2024-06-24

Condition(s): Diffuse Cutaneous Systemic Sclerosis
Product: Film-coated tablet, Major Ingredients Mannitol, microcrystalline cellulose, magnesium stearate, polyvinyl alcohol, macrogol, titanium dioxide and talc, Fipaxalparant

Primary endpoint: Change in FVC % predicted from Baseline to Week 52
Endpoint(s): 1.Change from Baseline in HAQ-DI at Week 52. 2.Change from Baseline in MDGA at Week 52. 3.Change from Baseline in PTGA at Week 52. 4.Change from Baseline in the Physical Effects subscale of the SSPRO-18 at Week 52. 5.Change from Baseline in the Physical Limitations subscale of the SSPRO-18 at Week 52. 6.Proportion of subjects with an mRSS decrease of ≥5 points and 25% from Baseline at Week 52. Please refer to protocol section 8.2

Source: https://euclinicaltrials.eu/ctis-public/view/2023-509782-20-00